EU clinical trial 2023-507569-24-00: Phase 2, Multicenter, Randomized, Parallel, 3-arm, Placebo-controlled Study to Assess Efficacy and Safety of CDR132L in Patients with Reduced Left Ventricular Ejection Fraction (≤ 45%) After Myocardial Infarction (HF-REVERT)
Protocol code: CDR132L-P2-01
Sponsor: Cardior Pharmaceuticals GmbH (Pharmaceutical company). Phase: Therapeutic exploratory (Phase II). Countries: Poland (ended), Spain (ended), Czechia (ended), Greece (ended), Netherlands (ended), Germany (ended), Hungary (ended).
Therapeutic area(s): Diseases [C] - Cardiovascular Diseases [C14]
Gender: Female, Male. Age: 18-64 years, 65+ years. Enrolment: 230.
Status: Ended. Start date (EU): 2022-06-20. End date (EU): 2025-02-26. End date: 2025-03-18. Decision date: 2024-10-28. Results received: Yes. Last updated: 2025-05-19.
Decision dates by country: PL: 2024-11-13, CZ: 2024-11-01, HU: 2024-10-28, ES: 2024-10-30, NL: 2024-10-28, DE: 2024-10-30, GR: 2024-11-01

Condition(s): Myocardial Infarction, Acute Heart Failure, Left Sided

Primary endpoint: Percent change from baseline (screening to occur at least 3 days (up to 14 days) after MI diagnosis as measured by ECHO [central laboratory]) in LVESVI at Month 6
Endpoint(s): Frequency of adverse events and abnormalities in clinical laboratory assessments, vital signs, physical examination, ECGs, and urinalysis, Change from baseline LVEF (absolute/relative) at Months 3, 6, and 12, Change from baseline LVESVI at Month 3 (absolute/relative), Month 6 (absolute), and Month 12 (absolute/relative), Change from baseline in absolute/relative troponin T (ng/L) at Months 3, 6, and 12, Change from baseline in absolute/relative values over time for the following efficacy-related biomarkers: N-terminal pro B-type natriuretic peptide (NT-proBNP), Well-being as evaluated by change from baseline at Months 6 and 12 in the following parameters: Mean KCCQ score and mean scores of subdomains (symptom burden, physical limitation, and quality of life), Heart failure as assessed by time to first event: Cardiovascular mortality; Hospitalization or emergency department visit(s) for HF conditions., Change from baseline in the following parameters at Months 3, 6, and 12: NYHA class; ECHO: Left ventricular end-diastolic volume (mL), early (E) and late (A) diastolic transmitral flow velocity, early diastolic mitral annular velocity (e'), left atrial volume index, stroke volume (mL), systolic ejection time (ms), and strain analysis for global longitudinal strain; ECG: QRS complex, ECG interpretation, Levels of exploratory biomarkers (e.g., MicroRNA-132 [miR-132] for target engagement, LIPCAR, NGAL, Gal-3, PRO-C6, cardiac fibrosis markers) and immunogenic parameters (e.g., anti-drug antibodies) over time.

Source: https://euclinicaltrials.eu/ctis-public/view/2023-507569-24-00